EU clinical trial 2023-504707-87-00: A bioequivalence vasoconstriction study comparing two clobetasol propionate 0.5 mg/g ointments after skin application in healthy adult human subjects
Protocol code: CO/BE/06/2022
Sponsor: BELUPO lijekovi i kozmetika d.d. (Pharmaceutical company). Phase: Human Pharmacology (Phase I)- Bioequivalence Study. Countries: Poland (ended).
Therapeutic area(s): Diseases [C] - Skin and Connective Tissue Diseases [C17]
Gender: Female, Male. Age: 18-64 years. Enrolment: 100.
Status: Ended. Start date (EU): 2023-11-20. End date (EU): 2024-02-12. Decision date: 2023-09-11. Results received: No. Last updated: 2023-11-15.

Condition(s): Localized, therapy-resistant inflammatory skin diseases, for which the use of topical corticosteroids with very high potency is indicated.

Source: https://euclinicaltrials.eu/ctis-public/view/2023-504707-87-00